EU clinical trial 2025-521756-39-00: C6001001 - A Study to Learn about the Study Medicine PF-08052667 in People with Bladder Cancer.
Protocol code: C6001001
Sponsor: Pfizer Inc. (Pharmaceutical company). Phase: Human Pharmacology (Phase I)- First administration to humans. Countries: France (ongoing, recruiting), Spain (ongoing, recruiting).
Therapeutic area(s): Diseases [C] - Neoplasms [C04]
Gender: Female, Male. Age: 18-64 years, 65+ years. Enrolment: 22.
Status: Ongoing, recruiting. Start date (EU): 2026-04-09. Decision date: 2026-03-02. Results received: No. Last updated: 2026-07-24.
Decision dates by country: FR: 2026-03-02, ES: 2026-03-02

Condition(s): Non-muscle invasive bladder cancer (NMIBC)

Source: https://euclinicaltrials.eu/ctis-public/view/2025-521756-39-00